EU clinical trial 2024-514792-17-00: ODORAT : Optimal dose of anti-lymphocyte globulin in kidney transplant recipients with low immunological risk
Protocol code: 2024/874
Sponsor: Centre Hospitalier Regional Universitaire (Hospital/Clinic/Other health care facility). Phase: Therapeutic exploratory (Phase II). Countries: France (ongoing, recruiting).
Therapeutic area(s): Not possible to specify
Gender: Female, Male. Age: 18-64 years, 65+ years. Enrolment: 18.
Status: Ongoing, recruiting. Start date (EU): 2025-06-24. Decision date: 2024-10-30. Results received: No. Last updated: 2024-10-30.

Condition(s): renal transplant, insufficiency renal
Product: ANTITHYMOCYTE IMMUNOGLOBULIN (RABBIT)

Primary endpoint: The primary outcome for the de-escalation study is the DLT defined by a T cell (CD3+) relative depletion above 30 % compared to baseline (Day 0) at the end of the Grafalon® induction treatment (Day 4).
Endpoint(s): Toxicities: Incidence and grade for Adverse events (AEs), drug related AEs, drug related AE leading to dose reduction or discontinuation during treatment, SAE and SUSAR, according to CTCAE V5.0., Pharmacokinetic study including for each dose level the calculation of the plasmatic clearance evaluated by the AUC of Grafalon® at day 0 and day 4 and the trough level of Grafalon® at each visit until month-3., The absolute count and proportion of different T and B cell subpopulations, NK cells, monocytes and neutrophils at each time point., Time to Transplant failure defined as the time since transplantation to either graft loss or death with a functioning graft. Return to dialysis or retransplantation defined graft loss. Overall survival defined as the time since transplantation to death. Time to kidney allograft acute rejection defined as the time since transplantation since to kidney allograft acute rejection., The infection up to 1 year after transplantation defined by : -the onset of a severe bacterial infection: all bacterial infections leading to patient hospitalization) -or an opportunistic infection: all types of infections that occur only in patients with an immune system deficiency and never in healthy patients (i.e. pneumocystis, tuberculosis, cryptococcosis, candidosis, Kaposi sarcoma, herpesviridae infections, B EBV lymphoma, HTLV T leukemia, toxoplasmosis, cryptococosis, polyomavirus vir, The atherosclerotic event up to 1 year after transplantation defined by major adverse cardiovascular events (MACE), The diagnosis of cancer up to 1 year after transplantation defined by all types and stages of post transplant solid organ, cutaneous or hematological malignancies, Renal function at 1 year post transplant evaluated by estimated glomerular filtration rate (eGFR) calculated by the creatinine clearance according to the formula CKD-EPI : eDFG = 141 x min(Scr/k, 1)α x max(Scr/k, 1)-1.209 x 0.993âge x 1.018 [if female] x 1.159 [if African ethnicity]

Source: https://euclinicaltrials.eu/ctis-public/view/2024-514792-17-00